EU clinical trial 2023-504443-13-00: A phase 3, randomised, 2-arm, parallel-group, double-blind, placebo-controlled trial to evaluate the efficacy and safety of subcutaneous methotrexate versus placebo in moderate to severe atopic dermatitis
Protocol code: MC-MTX.18/AD
Sponsor: Medac Gesellschaft fuer klinische Spezialprapaerate mbH (Pharmaceutical company). Phase: Therapeutic confirmatory (Phase III). Countries: Poland (ongoing, recruitment ended), Italy (ended), France (ended), Czechia (ongoing, recruitment ended).
Therapeutic area(s): Diseases [C] - Skin and Connective Tissue Diseases [C17]
Gender: Female, Male. Age: 18-64 years, 65+ years. Enrolment: 304.
Start date (EU): 2024-01-29. Decision date: 2023-11-17. Results received: No. Last updated: 2026-07-06.
Decision dates by country: FR: 2023-11-21, IT: 2023-11-20, PL: 2023-11-17, CZ: 2023-11-21

Condition(s): moderate to severe atopic dermatitis
Product: METHOTREXATE, DESOXIMETASONE, TACROLIMUS, Acidum folicum Léčiva 10 mg obalené tablety, METHOTREXATE, FOLIC ACID, placebo

Primary endpoint: EASI 75 response at the Trial Week 16 Visit
Endpoint(s): EASI, SCORAD, IGA, NRS and POEM scores or responses at different time points including Trial Week 4, Trial Week 8, Trial Week 12 and Trial Week 16, Adverse events (AE), treatment-related AEs, serious adverse events (SAEs) occurring from the Screening Visit until the Trial Week 16/24 Visit, and serious adverse reactions (SARs) occurring from start of the trial intervention until Trial Week 20/33 Visit - time points depending on participation in the extension phase or not. Change in vital signs and laboratory values., Change in DLQI, SCORAD, WPAI:GH, HADS, EQ-5D-5L and ADCT scores or responses from baseline to different time points including Trial Week 4, Trial Week 8, Trial Week 12, and Trial Week 16, EASI, IGA, NRS, SCORAD, DLQI, WPAI:GH, HADS, EQ-5D-5L and ADCT responses at Trial Week 24 or change in scores or responses between Trial Week 16 and Trial Week 24

Source: https://euclinicaltrials.eu/ctis-public/view/2023-504443-13-00